EU clinical trial 2025-524006-14-00: A Multicenter, Randomized, Double-Blind, Placebo-Controlled Phase 2 Study to Evaluate the Efficacy, Safety and Tolerability of Lesigercept in Adult Patients with Chronic Spontaneous Urticaria Who Are Inadequately Controlled by H1-Antihistamines (CLEAR)
Protocol code: YH35324-201
Sponsor: Yuhan Corp. (Pharmaceutical company). Phase: Therapeutic exploratory (Phase II). Countries: Bulgaria (ongoing, recruiting), Poland (ongoing, recruiting).
Therapeutic area(s): Diseases [C] - Skin and Connective Tissue Diseases [C17]
Gender: Female, Male. Age: 18-64 years, 65+ years. Enrolment: 46.
Status: Ongoing, recruiting. Start date (EU): 2026-04-20. Decision date: 2026-03-27. Results received: No. Last updated: 2026-05-31.
Decision dates by country: BG: 2026-05-28, PL: 2026-05-31

Condition(s): Chronic Spontaneous Urticaria
Product: Subcutaneous injection of with no active ingredient contained

Primary endpoint: Change from baseline in UAS7 at Week12
Endpoint(s): 1. Proportion of participants achieving complete control (UAS7=0) at Week 12, 2. Proportion of participants achieving well-controlled urticaria (UAS7≤6) at Week 12, 3. Cumulative number of weeks with an AAS7=0 response between baseline and Week 12, 4. Change from baseline in DLQI score at Week 12, 5. Safety endpoints will be included but not be limited to: - Occurrence of treatment emergent adverse events during the study; - Occurrence of treatment emergent serious adverse events during the study

Source: https://euclinicaltrials.eu/ctis-public/view/2025-524006-14-00